EU clinical trial 2023-508958-26-00: Efficacy, safety, and dose-response of a Live Biotherapeutic Product (BGY-1601-VT, vaginal tablet) as a first-line monotherapy in women with acute vaginal infection: a randomized, double-blind, placebo-controlled study
Protocol code: BGY-1601-VT-001
Sponsor: Nexbiome Therapeutics (Pharmaceutical company). Phase: Phase I and Phase II (Integrated)- First administration to humans. Countries: France (ended), Germany (ended).
Therapeutic area(s): Diseases [C] - Bacterial Infections and Mycoses [C01]; Diseases [C] - Female Urogenital Diseases and Pregnancy Complications [C13]
Gender: Female. Age: 18-64 years. Enrolment: 165.
Status: Ended. Start date (EU): 2024-10-16. End date (EU): 2026-02-20. Decision date: 2024-06-21. Results received: No. Last updated: 2026-02-13.
Decision dates by country: FR: 2024-06-24, DE: 2024-06-21

Condition(s): Gynaecological
Product: The Placebo consists in tablet composed with excipients mixed for vaginal administration. The tablet does not contain any active ingredient. Microcrystalline cellulose Sub12626mig 658,14mg ; Hypromellose Sub02622mig 25,86mg ; Calcium hydrogen phosphate dihydrate Sub11771mig 172,4mg ; Magnesium stearate Sub12527mig 4,31mg ; Yellow iron oxide Sub15934mig 1,29mg, BGY-1601-VT

Primary endpoint: Percentage of responders, i.e. participants with clinical cure at V2 AND no rescue therapy started before V2.
Endpoint(s): Percentage of participants with clinical cure at the time point AND no rescue therapy started., Percentage of participants with improved symptoms at the time point, related to D0 (self-assessment): PGI-C scale ≤ 2 AND no rescue therapy started., Percentage of participants with improved symptoms at the time point, related to D0 (as per the investigator’s assessment): CGI-C scale ≤ 2 AND no rescue therapy started., Percentage of participants who started a rescue therapy before the time point., Evolution of each symptom from D0 to the time point, as per the participant’s assessment (resolution / improvement / no change / worsening): Itching / pruritus, burning / irritation, pain, leucorrhea / vaginal discharge., Evolution of each symptom from D0 to the time point, as per the investigator’s assessment (resolution / improvement / no change / worsening): Leucorrhoea / vaginal discharge, edema, erythema, ulceration, pH., Time to resolution of all symptoms present at D0, as reported in the participant’s diary., Time to symptom recurrence after resolution, if applicable, as reported in the participant’s diary., Time to rescue therapy., Number of events / participants with adverse events (Aes), depending on their classification (systemic / local; severe; treatment-emergent)., Quantification of Lcr35 in the vaginal microbiota, from quantitative polymerase chain reaction (qPCR) on vaginal secretions at the time point.

Source: https://euclinicaltrials.eu/ctis-public/view/2023-508958-26-00